EU clinical trial 2023-507680-19-00: A Phase 2 Randomized, Double-blind, Placebo-controlled Study to Evaluate the Efficacy and Safety of HZN-1116 in Participants With Sjögren’s Syndrome.
Protocol code: HZNP-HZN-1116-201
Sponsor: Horizon Therapeutics Ireland Designated Activity Company (Pharmaceutical company). Phase: Therapeutic exploratory (Phase II). Countries: Austria (ended), Germany (ended), Spain (ended), Poland (ended), Greece (ended), Bulgaria (ended), Hungary (ended), Italy (ended), Portugal (ended), France (ended), Ireland (ended).
Therapeutic area(s): Diseases [C] - Immune System Diseases [C20]
Gender: Female, Male. Age: 18-64 years, 65+ years. Enrolment: 151.
Status: Ended. Start date (EU): 2024-11-28. End date (EU): 2026-03-12. End date: 2026-04-28. Decision date: 2024-10-08. Results received: No. Last updated: 2025-07-28.
Decision dates by country: PT: 2024-10-09, HU: 2024-10-09, FR: 2024-11-05, ES: 2024-10-14, IE: 2024-10-11, GR: 2024-10-11, DE: 2024-10-10, PL: 2024-11-13, BG: 2024-10-11, IT: 2024-10-14, AT: 2024-10-08

Condition(s): Sjögren’s Syndrome
Product: HZN-1116, HZN-1116, commercially available 0.9% (w/v) saline solution intended for SC administration, HZN-1116

Primary endpoint: Population #1:Change from baseline in European Alliance of Associations for Rheumatology Sjögren’s Syndrome Disease Activity Index (ESSDAI) total score at Week XX, Population #2:Change from baseline in European Alliance of Associations for Rheumatology Sjögren’s Syndrome Patient Reported Index (ESSPRI) total score at Week XX
Endpoint(s): Population #1: - Change from baseline in ESSDAI total score at Week XX, Population #1: - Proportion of participants achieving ESSDAI[5] response at Week XX and XX without premature discontinuation from treatment and without receiving rescue or potentially confounding therapy, Population #1: - Change from baseline in tender joint count (TJC) and swollen joint count (SJC) at the Week XX and XX time points, Population #1: - Change from baseline in 36-item Short Form Survey (SF-36) physical component score (PCS) and mental component score (MCS) at the Week XX and XX time points, Population #1: - Change from baseline in PROMIS-Fatigue SF-10a at Week XX and Week XX, Population #2: - - Change from baseline in DASPRI total score at Week XX, Population #2: - Proportion of participants achieving ESSPRI[1.5] response without premature discontinuation from treatment and without receiving rescue or potentially confounding therapy at Week XX, Population #2: - Change from baseline in ESSPRI -pain, -fatigue, and -dryness domains at Week XX, Population #2: - Change from baseline in SF-36 PCS and MCS at Week XX, Population #2: - Change from baseline in PROMIS-Fatigue SF-10a at Week XX, Population #1 and #2: - PK of HZN-1116, Population #1 and #2: - Proportion of participants who develop anti-drug antibodies (ADA) over time

Source: https://euclinicaltrials.eu/ctis-public/view/2023-507680-19-00